EU clinical trial 2024-515417-17-00: A study in people with obesity to test the effects of different doses of BI 456906 compared with semaglutide on glucagon receptor activity in the liver
Protocol code: 14040047
Sponsor: Boehringer Ingelheim International GmbH (Pharmaceutical company). Phase: Human Pharmacology (Phase I)- Other. Countries: Netherlands (ongoing, recruitment ended).
Therapeutic area(s): Phenomena and Processes [G] - Metabolism [G03]
Gender: Female, Male. Age: 18-64 years. Enrolment: 30.
Status: Ongoing, recruitment ended. Start date (EU): 2024-10-01. Decision date: 2024-10-28. Results received: No. Last updated: 2025-11-25.

Condition(s): No targeted indication. Male and female subjects with obesity.

Source: https://euclinicaltrials.eu/ctis-public/view/2024-515417-17-00